EU clinical trial 2024-516755-40-00: Exendin PET/CT for imaging of paragangliomas
Sponsor: Stichting Radboud universitair medisch centrum (Hospital/Clinic/Other health care facility). Phase: Therapeutic exploratory (Phase II). Countries: Netherlands (ongoing, recruiting).
Therapeutic area(s): Diseases [C] - Pathological Conditions, Signs and Symptoms [C23]; Diseases [C] - Hormonal diseases [C19]
Gender: Female, Male. Age: 18-64 years, 65+ years. Enrolment: 10.
Status: Ongoing, recruiting. Start date (EU): 2024-09-27. Decision date: 2024-09-27. Results received: No. Last updated: 2024-09-27.

Condition(s): paragangliomas
Product: EXENATIDE

Primary endpoint: Detection rate of PGLs (paragangliomas) using 68Ga-exendin-4 PET/CT
Endpoint(s): optimal timepoint for imaging PGLs using 68Ga-exendin-4 PET/CT, Comparison of quantitative imaging paramters (SUV, tumor-to-background ratio, contract-to-noise ratio) between Optimal timepoint for imaging PGLs using 68Ga-exendin-4 PET/CT, 18F-FDG PET and SSTR PET, correlation between GLP-1R expression and tracer uptake in the PGLs, Correlation quantitative imaging results and IHC data to the genetic origin of the PGLs

Source: https://euclinicaltrials.eu/ctis-public/view/2024-516755-40-00